EU clinical trial 2022-500990-16-00: A Phase 2 Precision Oncology Study of Biomarker-Directed, Pembrolizumab- (MK-3475, SCH 900475) Based Combination Therapy for Advanced Non-Small Cell Lung Cancer (KEYNOTE-495; KeyImPaCT)
Protocol code: MK-3475-495
Sponsor: Merck Sharp & Dohme LLC (Pharmaceutical company). Phase: Therapeutic exploratory (Phase II). Countries: Italy (ended), Spain (ended), Poland (ended).
Therapeutic area(s): Diseases [C] - Neoplasms [C04]
Gender: Female, Male. Age: 18-64 years, 65+ years. Enrolment: 84.
Status: Ended. Start date (EU): 2018-12-19. End date (EU): 2025-06-13. End date: 2025-06-14. Decision date: 2024-03-22. Results received: Yes. Last updated: 2025-06-06.
Decision dates by country: ES: 2024-03-22, IT: 2024-04-22, PL: 2024-03-25

Condition(s): Stage IV non-small cell lung cancer
Product: favezelimab, quavonlimab, Lenvatinib, KEYTRUDA 25 mg/mL concentrate for solution for infusion, Lenvatinib

Primary endpoint: Objective Response Rate (ORR) per Response Evaluation Criteria in Solid Tumors 1.1 (RECIST 1.1)
Endpoint(s): Progression Free Survival (PFS) per RECIST 1.1, Overall Survival (OS), Number of Participants Experiencing Adverse Events (AEs), Number of Participants Discontinuing Study Drug Due to AEs

Source: https://euclinicaltrials.eu/ctis-public/view/2022-500990-16-00